EU clinical trial 2023-508013-16-00: A prospective, randomized, double-blind placebo-controlled multicentre study with mannan-conjugated birch pollen allergoids administered subcutaneously to adolescent and adult patients with birch pollen-induced allergic rhinitis or rhinoconjunctivitis.
Protocol code: T502-SIT-068
Sponsor: CCDRD Cooperative Clinical Drug Research and Development AG, Inmunotek S.L., ClinCompetence Cologne GmbH (Pharmaceutical company). Phase: Therapeutic confirmatory (Phase III). Countries: Germany (ended), Poland (ended).
Therapeutic area(s): Diseases [C] - Immune System Diseases [C20]
Gender: Female, Male. Age: 0-17 years, 18-64 years. Enrolment: 600.
Status: Ended. Start date (EU): 2024-02-26. End date (EU): 2024-06-28. Decision date: 2024-02-14. Results received: Yes. Last updated: 2024-02-16.
Decision dates by country: DE: 2024-02-14, PL: 2024-02-16

Condition(s): Birch pollen induced allergic rhinitis or rhinoconjunctivitis
Product: placebo will be identical in appearance to the investigational medicinal product, Mannan-conjugated allergoid (polymerized) Betula pendula parenteral vaccine

Primary endpoint: The clinical impact of T502 treatment will be assessed by comparing the Combined Symptom and Medication Score (CSMS) over the peak birch pollen season 2024 between the placebo and the active treatment group.

Source: https://euclinicaltrials.eu/ctis-public/view/2023-508013-16-00